EU clinical trial 2023-503692-24-00: A Multicenter, Randomized, Double‑blind, Placebo‑controlled, Phase III Study to Evaluate the Efficacy and Safety of Anifrolumab in Adults with Chronic and/or Subacute Cutaneous Lupus Erythematosus who are Refractory and/or Intolerant to Antimalarial Therapy
Protocol code: D346BC00001
Sponsor: AstraZeneca AB (Pharmaceutical company). Phase: Therapeutic confirmatory (Phase III). Countries: Bulgaria (ongoing, recruitment ended), Denmark (ongoing, recruitment ended), Spain (ongoing, recruitment ended), Poland (ongoing, recruitment ended), Netherlands (ongoing, recruitment ended), Greece (ongoing, recruitment ended), Germany (ongoing, recruitment ended), Austria (ongoing, recruitment ended), France (ongoing, recruitment ended), Italy (ongoing, recruitment ended), Portugal (ongoing, recruitment ended), Romania (ongoing, recruitment ended), Slovakia (ongoing, recruitment ended).
Therapeutic area(s): Diseases [C] - Skin and Connective Tissue Diseases [C17]
Gender: Female, Male. Age: 18-64 years, 65+ years. Enrolment: 344.
Status: Ongoing, recruitment ended. Start date (EU): 2024-09-25. Decision date: 2024-08-27. Results received: No. Last updated: 2026-08-05.
Decision dates by country: SK: 2025-04-24, FR: 2024-08-28, BG: 2024-08-28, PT: 2025-03-31, GR: 2024-08-28, NL: 2024-08-29, PL: 2024-08-30, IT: 2024-08-29, RO: 2025-05-12, ES: 2024-08-27, AT: 2024-09-02, DE: 2024-08-30, DK: 2024-08-28

Condition(s): Cutaneous Lupus Erythematosus
Product: Anifrolumab, Matching placebo solution for injection in aPFS; 0.8 mL fill volume

Primary endpoint: Number of participants with CLASI-70 response at Week 24.
Endpoint(s): Total CLASI A score, change from baseline at Week 24., - Number of participants with CLASI-70 response at Week 12. - Participants with ≥ 7 point reduction from baseline in CLASI A total score (yes/no) at Week 12. - Number of participants with CLASI 50 response at Week 12., Change from baseline at Week 24 in Skindex-29+3 domain scores., - Time from IP start date to CLASI 70 response; - Time from IP start date to CLASI 50 response., Number of participants with CLASI 50 response at Week 24., Number of participants who are primary endpoint responders (CLASI-70 response at Week 24) and sustain CLASI-70 response up to and including Week 52., - Pharmacokinetic (PK) assessment (Ctrough) for subcutaneously administered anifrolumab in participants with CLE will be performed., - Pharmacodynamic (PD) assessment for subcutaneously administered anifrolumab in participants with CLE will be performed., - The immunogenicity of subcutaneously administered anifrolumab in participants with CLE will be evaluated., Number of participants with adverse events.

Source: https://euclinicaltrials.eu/ctis-public/view/2023-503692-24-00